EU clinical trial 2024-517483-34-00: Randomized, double-blind, multicenter, parallel group, placebo-controlled study to evaluate the efficacy and safety of phenofibrate treatment on the functions of beta cells in children and adolescents with newly diagnosed of type 1 diabetes
Protocol code: PRIFEN-01
Sponsor: Medical University Of Warsaw (Educational Institution). Phase: Therapeutic exploratory (Phase II). Countries: Poland (ended).
Therapeutic area(s): Diseases [C] - Hormonal diseases [C19]
Gender: Female, Male. Age: 0-17 years. Enrolment: 98.
Status: Ended. Start date (EU): 2022-09-21. End date (EU): 2026-01-31. Decision date: 2024-09-22. Results received: Yes. Last updated: 2025-06-10.

Condition(s): Evaluation of the effect of phenofibrate on the functions of beta cells in children with new diagnosis of type 1 diabetes
Product: Placebo, Grofibrat S, 160 mg, tabletki powlekane

Primary endpoint: Assessment of pancreatic beta cell function by comparing the AUC area under the curve in the C-peptide stimulation test: Change in the mean insulin secretion measured based on the C-peptide area under the curve in the stimulation test at individual time points in the compared groups of patients
Endpoint(s): • Fasting c-peptide concentration and maximum c-peptide concentration in the stimulation test, • Parameters of diabetes control and glucose fluctuations (including HbA1c, mean blood glucose with standard deviation, variability index, time spent in normoglycemia), • Daily and basic insulin requirements • Inflammation markers • Safety and tolerance of the fenofibrate

Source: https://euclinicaltrials.eu/ctis-public/view/2024-517483-34-00